EU clinical trial 2024-516415-24-03: Rapid sequence emergence of general Anaesthesia
Sponsor: Stichting Radboud universitair medisch centrum (Hospital/Clinic/Other health care facility). Phase: Therapeutic use (Phase IV). Countries: Netherlands (authorised, recruitment pending).
Therapeutic area(s): Analytical, Diagnostic and Therapeutic Techniques and Equipment [E] - Anesthesia and Analgesia [E03]; Analytical, Diagnostic and Therapeutic Techniques and Equipment [E] - Investigative Techniques [E05]; Not possible to specify
Gender: Female, Male. Age: 18-64 years. Enrolment: 10.
Status: Authorised, recruitment pending. Decision date: 2025-12-02. Results received: No. Last updated: 2025-12-02.

Condition(s): General anesthesia
Product: Sugammadex hameln 100 mg/ml oplossing voor injectie, Naloxon HCl Accord 0,4 mg/ml, oplossing voor injectie / infusie in een voorgevulde spuit, ANEXATE 0,5 mg/5 ml, solution injectable (I.V.), REMIMAZOLAM, Sufentanil Viatris 5 microgram/ml oplossing voor injectie, Esmeron 10 mg/ml, oplossing voor injectie

Primary endpoint: Time to the return of spontaneous breathing
Endpoint(s): Time to opening the eyes, Time to return of airway reflexes (swallow-ing, coughing), Respiratory effects (saturation, respiratory rate, capnography), Hemodynamic effects (blood pressure, heart rate), Bispectral Index Score (BIS), Neuromuscular block depth, Physician satisfaction, Total time to emerge from anaesthesia (to-tally awake, as before induction)

Source: https://euclinicaltrials.eu/ctis-public/view/2024-516415-24-03